EU clinical trial 2024-516152-17-00: Towards organ preservation and cure via immunotherapy in cutaneous squamous cell carcinoma patients, normally undergoing extensive curative surgery and radiotherapy: Matisse-2
Sponsor: Het Nederlands Kanker Instituut-Antoni van Leeuwenhoek Ziekenhuis Stichting (Hospital/Clinic/Other health care facility). Phase: Therapeutic exploratory (Phase II). Countries: Netherlands (ongoing, recruiting).
Therapeutic area(s): Diseases [C] - Neoplasms [C04]
Gender: Female, Male. Age: 18-64 years, 65+ years. Enrolment: 41.
Status: Ongoing, recruiting. Start date (EU): 2025-04-24. Decision date: 2025-01-20. Results received: No. Last updated: 2026-07-22.

Condition(s): Cutaneous squamous cell carcinoma
Product: OPDIVO 10 mg/mL concentrate for solution for infusion., YERVOY 5 mg/ml concentrate for solution for infusion

Primary endpoint: A clinical complete remission rate of at least 30% at 12, 18 and 24 months FU after only immunotherapy, without surgery, radiotherapy, or maintenance immunotherapy.
Endpoint(s): Rate and type of immune-related AEs (CTCAE v5.0, Clavien-Dindo);, Health-related QoL (EORTC QLQ-C30) between responders (undergoing only immunotherapy) and non-responders (undergoing standard of care after neoadjuvant immunotherapy);, Treatment duration and treatment stops;, Survival (DSS, RFS (RECIST v1.1), EFS and OS) at 12, 18 and 24 months FU;, Survival of MATISSE 2 patients will also be compared to survival of a historic cohort of CSCC patients previously treated at the NKI-AVL with standard of care surgery ± RT without neoadjuvant immunotherapy;, Healthcare needs and consumption will be compared between MATISSE 2 responders (undergoing only immunotherapy) and non-responders (undergoing standard of care after neoadjuvant immunotherapy);, Healthcare utilisation of MATISSE 2 patients will also be compared to healthcare utilisation of a historic cohort of CSCC patients previously treated at the NKI-AVL with standard of care surgery ± RT without neoadjuvant immunotherapy;, Cost-effectiveness will be assessed for MATISSE 2 responders (undergoing only immunotherapy) and non-responders (undergoing standard of care after neoadjuvant immunotherapy);, Costs of MATISSE 2 patients will be compared to costs of a historic cohort of CSCC patients previously treated at the NKI-AVL with standard of care surgery ± RT without neoadjuvant immunotherapy;

Source: https://euclinicaltrials.eu/ctis-public/view/2024-516152-17-00